EU clinical trial 2025-521230-29-00: A multicenter, double-blind, placebo-controlled, clinical trial to evaluate the efficacy and safety of two concentrations of a mixture of depigmented polymerized allergenic extracts of D. pteronyssinus and D. farinae, in patients suffering from allergic rhinoconjunctivitis with or without controlled asthma
Sponsor: LETI Pharma S.L.U. (Pharmaceutical company). Phase: Therapeutic confirmatory (Phase III). Countries: Spain (authorised, recruitment pending).
Therapeutic area(s): Diseases [C] - Immune System Diseases [C20]
Gender: Female, Male. Age: 0-17 years, 18-64 years, 65+ years. Enrolment: 360.
Status: Authorised, recruitment pending. Decision date: 2025-10-29. Results received: No. Last updated: 2026-05-11.

Condition(s): Allergic rhinoconjunctivitis to Dermatophagoides pteronyssinus and Dermatophagoides farinae
Product: CPT Dermatophagoides pteronyssinus LETI 100 HEP/ml, Formodual 100/6 microgramos/pulsación Solución para inhalación en envase a presión, Montelukast Teva 10 mg comprimidos recubiertos con película EFG, Budesonida Aldo-Unión- 200 microgramos/pulsación suspensión para inhalación en envase a presión., Salbutamol Aldo-Unión 100 microgramos/dosis suspensión para inhalación en envase a presión, AVAMYS 27.5 micrograms/spray, nasal spray suspension, Formodual Nexthaler 200 microgramos/6 microgramos por inhalación polvo para inhalación., PRICK TEST Dermatophagoides farinae LETI, 100 HEP/ml Pricktestlösung., Desloratadine 5 mg film-coated tablets, PRICK TEST Dermatophagoides pteronyssinus LETI, 100 HEP/ml Pricktestlösung., Terbasmin Turbuhaler 500 microgramos/inhalación polvo para inhalación, REACTINE Levocabastina 0,5mg/ml colirio en suspensión, PLACEBO (Depigoid), Depigoid Mite-Mix (50 DPP/ml + 50 DPP/ml), Formodual Nexthaler 100 microgramos/6 microgramos por inhalación polvo para inhalación, Depigoid FORTE Mite-Mix (150 DPP/ml + 150 DPP/ml)

Primary endpoint: The clinical efficacy of both concentrations of SCIT individually, compared to placebo, will be evaluated through the change in the cSMS score from baseline to the timepoint after 12 SCIT doses have been administered. Data collection will be carried out via an electronic diary installed on the patient's mobile device at the time of the first treatment administration.
Endpoint(s): Clinical efficacy for rhinoconjunctivitis will be evaluated by the change in the cSMS score from baseline to the timepoint after 6 SCIT administrations, as well as 1 and 2 years after the end of the first study period., Clinical efficacy based on the progression of rhinoconjunctivitis symptoms will be evaluated by the change in the dSS score from baseline to the timepoints after 6 and 12 SCIT administrations, as well as 1 and 2 years after the end of the first study period., Clinical efficacy based on the evolution of medication use for rhinoconjunctivitis will be evaluated by the change in the dMS score from baseline to the timepoints after 6 and 12 SCIT administrations, as well as 1 and 2 years after the end of the first study period., Efficacy in terms of the allergen concentration required to elicit an allergic response will be evaluated by comparing the dose of D. pteronyssinus extract needed to trigger a positive response in the CPT at the start of treatment and after 12 SCIT administrations, as well as 1 and 2 years after the end of the first study period., The severity of allergic rhinoconjunctivitis will be evaluated according to the ARIA guideline classification from baseline to the timepoints after 6 and 12 SCIT administrations, as well as 1 and 2 years after the end of the first study period., The progression of allergic rhinoconjunctivitis symptoms will be evaluated through the change in the patient-reported VAS (Visual Analogue Scale) score from baseline to the timepoints after 6 and 12 SCIT administrations, as well as 1 and 2 years after the end of the first study period. Patients will complete this scale manually, in paper format., The immune response will be evaluated at baseline, after 12 SCIT administrations, and 1 and 2 years after the end of the first study period by assessing changes in the levels of the following immunological parameters: Total and specific IgE against D. pteronyssinus and D. farinae Total and specific IgG4 against D. pteronyssinus and D. farinae Total IgA2., Quality of life related to allergic rhinoconjunctivitis will be evaluated based on the following patient-reported outcomes (PROs): Mean change in the RQLQ questionnaire score from baseline to after 6 and 12 SCIT administrations, as well as 1 and 2 years after the end of the first study period. This PRO will be specifically assessed in adult patients. Patients will complete this questionnaire manually, in paper format., Quality of life related to allergic rhinoconjunctivitis will be evaluated based on the following patient-reported outcome (PRO): Mean change in the AdolRQLQ questionnaire score from baseline to after 6 and 12 SCIT administrations, as well as 1 and 2 years after the end of the first study period. This PRO will be specifically assessed in adolescent patients aged 12 to 17 years., Patient satisfaction will be evaluated using the ESPIA score after 12 SCIT administrations, as well as 1 and 2 years after the end of the first study period. Patients will complete this questionnaire manually, in paper format., The safety profile will be assessed based on the number and percentage of patients who have experienced at least one of the reported events, including the number of episodes/symptoms and the percentage per patient, during the 3-year SCIT treatment period. The severity and causality of each event will also be evaluated., The clinical efficacy based on the evolution of asthma symptoms will be assessed by the change in the dSSa score from baseline to after the 6th and 12th SCIT administrations, as well as 1 and 2 years after the end of the first study period., The clinical efficacy based on the evolution of medication use will be assessed by the change in the dMSa score from baseline to after the 6th and 12th SCIT administrations, as well as 1 and 2 years after the end of the first study period., Pulmonary function will be assessed based on the mean change in FEV1 using spirometry, while pulmonary inflammation will be assessed based on the mean change in FeNO from baseline to after the 6th and 12th SCIT administrations, as well as 1 and 2 years after the end of the first study period., 14. Asthma-related quality of life will be assessed in adult patients based on the mean change in AQLQ score, and in patients aged 12 to 17 years based on the mean change in pAQLQ score, from baseline to after the 6th and 12th SCIT administrations, as well as 1 and 2 years after the end of the first study period., Asthma control will be assessed in all patients based on the mean change in ACT score from baseline to after the 6th and 12th SCIT administrations, as well as 1 and 2 years after the end of the first study period. Patients will complete these questionnaires manually, in paper format., The evolution of asthma severity will be assessed based on the change in asthma classification according to the GINA guidelines from baseline to after the 6th and 12th SCIT administrations, as well as 1 and 2 years after the end of the first study period., The evolution of exacerbations will be assessed at each treatment administration based on the number, severity, and duration of exacerbations experienced by the patients from baseline to after the 12th SCIT administration, as well as 1 and 2 years after the end of the first study period.

Source: https://euclinicaltrials.eu/ctis-public/view/2025-521230-29-00